EU clinical trial 2024-513302-56-00: A Multicenter, Randomized, Double-blind, Placebo-controlled Study to Assess the Efficacy, Safety, and Tolerability of ITI-1284 as an Adjunctive Treatment in Patients with Generalized Anxiety Disorder Who Have an Inadequate Response to Generalized Anxiety Disorder Treatment
Protocol code: ITI-1284-301
Sponsor: Intra-Cellular Therapies Inc. (Pharmaceutical company). Phase: Therapeutic exploratory (Phase II). Countries: Czechia (ongoing, recruiting), Bulgaria (ongoing, recruiting), Poland (ongoing, recruiting), Finland (authorised, recruitment pending).
Therapeutic area(s): Psychiatry and Psychology [F] - Mental Disorders [F03]
Gender: Female, Male. Age: 18-64 years, 65+ years. Enrolment: 354.
Start date (EU): 2025-11-17. Decision date: 2024-12-11. Results received: No. Last updated: 2026-06-05.
Decision dates by country: CZ: 2024-12-11, PL: 2024-12-16, FI: 2025-12-17, BG: 2024-12-16

Condition(s): Generalized Anxiety Disorder
Product: ITI-1284, Placebo, ITI-1284

Primary endpoint: Primary efficacy endpoint is change from baseline to Week 6 in HAM-A total score.
Endpoint(s): Key secondary efficacy endpoint is change from baseline to Week 6 in CGI-S score., Additional secondary efficacy endpoints may include by visit: change from baseline in HAM-A total score; CGI-S score; or Q-LES-Q score; ≥ 50% reduction from baseline in HAM-A total score; HAM-A remission (HAM-A total score ≤ 7); CGI-I scale score; change from baseline in MADRS total score; PGI-C scale score

Source: https://euclinicaltrials.eu/ctis-public/view/2024-513302-56-00